EU clinical trial 2023-509807-34-00: A Phase 2 Double-Blind, Randomized, Placebo-Controlled Trial to Evaluate the Efficacy and Safety of Intravenous Sabirnetug in Early Alzheimer’s Disease
Protocol code: ACU193-201
Sponsor: Acumen Pharmaceuticals Inc. (Pharmaceutical company). Phase: Therapeutic exploratory (Phase II). Countries: Germany (ongoing, recruitment ended), France (not authorised), Spain (ongoing, recruitment ended).
Therapeutic area(s): Diseases [C] - Nervous System Diseases [C10]
Gender: Female, Male. Age: 18-64 years, 65+ years. Enrolment: 175.
Start date (EU): 2024-08-12. Decision date: 2024-07-17. Results received: No. Last updated: 2026-03-12.
Decision dates by country: FR: 2024-07-22, ES: 2024-07-17, DE: 2024-07-19

Condition(s): Early Alzheimer’s Disease (Mild Cognitive Impairment and Mild Dementia Due to Alzheimer’s Disease)
Product: Amyvid 800 MBq/mL solution for injection, ACU193 matching Placebo, Neuraceq 300 MBq/mL solution for injection, ACU193, VIZAMYL 400 MBq/mL solution for injection

Primary endpoint: Change from Baseline to Week 80 in the iADRS score.
Endpoint(s): 1. Change from Baseline to Week 80 in the ADCS-iADL, ADAS-Cog13, CDR-SB, and MMSE., 2. Change from Baseline to Week 80 in QoL-AD, 3. Further Secondary, Clinical, Safety, Pharmacodynamic, Pharmacokinetics, Pharmacogenomic, Blood and CSF Biomarker and Exploratory Endpoints are visible in the study protocol., 4. OLE: Changes from Baseline to Week 104 and Week 132 for iADRS, CDR-SB, ADCS-iADL, ADAS-Cog13, and MMSE as measured by delayed-start analysis.

Source: https://euclinicaltrials.eu/ctis-public/view/2023-509807-34-00